EU clinical trial 2023-506030-70-00: 68Ga-FAPI-46 PET for imaging of gastrointestinal cancers: A prospective interventional single-arm clinical trial (FAPI-PET-GI)
Protocol code: FAPI-PET-GI
Sponsor: Universitaetsklinikum Essen AöR (Hospital/Clinic/Other health care facility). Phase: Phase II and Phase III (Integrated). Countries: Germany (authorised, recruitment pending).
Therapeutic area(s): Not possible to specify
Gender: Female, Male. Age: 18-64 years, 65+ years. Enrolment: 150.
Status: Authorised, recruitment pending. Decision date: 2025-03-06. Results received: No. Last updated: 2026-06-16.

Condition(s): Gastrointestinal cancers (including hepatocellular carcinoma, cholangiocarcinoma, gastric cancers, pancreatic cancer, colorectal cancer and oesophageal cancer)

Primary endpoint: Positive predictive value (PPV) on a per-region- and per-patient-basis of 68Ga-FAPI-46 PET for detection of gastrointestinal cancers, confirmed by histopathology/ biopsy (reached for ≥ 75%)
Endpoint(s): Sensitivity and specificity of 68Ga-FAPI-46 PET on a per-patient and per-region-basis for detection of gastrointestinal cancers confirmed by histopathology/ biopsy (separate for regional, extra-regional and distant locations), Detection rate of 68Ga-FAPI-46 PET versus previous standard imaging on a per-patient and per-region basis for detection of tumour location, also stratified by tumour marker serum level, Sensitivity and specificity of 68Ga-FAPI-46 PET versus previous standard imaging on a per-patient and per-region-basis for detection of tumour lesions confirmed by combined histopathology/ biopsy/ follow-up imaging/ clinical follow-up reference standard (separate for regional, extra-regional and distant locations, Inter-reader reproducibility, Impact on therapy management will be evaluated by pre- & post-imaging questionnaires sent to the treating physicians, Change in staging/ prognostic groups, Association between 68Ga-FAPI-46 PET uptake intensity and histopathologic FAP expression, Incidence and severity of Adverse Events (AEs) and Serious Adverse Events (SAEs) including vital signs and changes in laboratory parameters

Source: https://euclinicaltrials.eu/ctis-public/view/2023-506030-70-00